EU clinical trial 2025-522124-26-00: Randomised, crossover bioequivalence clinical trial of escitalopram 10 mg capsules versus escitalopram 10 mg film-coated tablets, after a single oral dose administration to healthy volunteers under fasting conditions.
Protocol code: UECHUP-ESC/25-3
Sponsor: Laboratorios Alter S.A. (Pharmaceutical company). Phase: Human Pharmacology (Phase I)- Bioequivalence Study. Countries: Spain (ended).
Therapeutic area(s): Psychiatry and Psychology [F] - Mental Disorders [F03]
Gender: Female, Male. Age: 18-64 years. Enrolment: 36.
Status: Ended. Start date (EU): 2025-08-18. End date (EU): 2025-10-10. Decision date: 2025-07-04. Results received: No. Last updated: 2025-07-04.

Condition(s): Antidepressants

Source: https://euclinicaltrials.eu/ctis-public/view/2025-522124-26-00